EU clinical trial 2023-508156-20-00: A Phase III Randomized Controlled Multicentre Trial of Percutaneous Hepatic Perfusion in Combination with Ipilimumab and Nivolumab Compared to Ipilimumab and Nivolumab Only in Patients with Uveal Melanoma Liver Metastases – the SCANDIUM III trial
Sponsor: Vaestra Goetalandsregionen (Hospital/Clinic/Other health care facility). Phase: Therapeutic confirmatory (Phase III). Countries: Sweden (ongoing, recruiting), Norway (ongoing, recruiting).
Therapeutic area(s): Analytical, Diagnostic and Therapeutic Techniques and Equipment [E] - Therapeutics [E02]; Diseases [C] - Neoplasms [C04]
Gender: Female, Male. Age: 18-64 years, 65+ years. Enrolment: 50.
Status: Ongoing, recruiting. Start date (EU): 2024-06-10. Decision date: 2024-04-24. Results received: No. Last updated: 2026-04-27.
Decision dates by country: SE: 2024-04-24, NO: 2026-03-13

Condition(s): Uveal Melanoma Liver Metastases
Product: Alkeran 50 mg pulver och vätska till injektionsvätska, lösning, YERVOY 5 mg/ml concentrate for solution for infusion, OPDIVO 10 mg/mL concentrate for solution for infusion.

Primary endpoint: Progression-free survival (PFS)
Endpoint(s): Incidence and severity of adverse events (AEs) and serious adverse events (SAEs), Objective response rate (ORR), Clinical benefit rate (CBR), Hepatic progression-free survival (hPFS), Extrahepatic progression-free survival (xhPFS), Overall survival (OS), Melanoma-specific survival (MSS), Duration of response (DOR), Quality of Life (QoL), ctDNA zero-conversion rate at 24 weeks, Predictive and prognostic biomarker discovery

Source: https://euclinicaltrials.eu/ctis-public/view/2023-508156-20-00